EU clinical trial 2023-509275-17-00: A randomized, open-label, parallel-group, non-inferiority study comparing efficacy, safety, and tolerability of remibrutinib after switching from ocrelizumab in participants living with relapsing multiple sclerosis, followed by open-label treatment with remibrutinib
Protocol code: CLOU064C12306
Sponsor: Novartis Pharma AG (Pharmaceutical company). Phase: Therapeutic confirmatory (Phase III). Countries: Portugal (ongoing, recruiting), France (ongoing, recruiting), Italy (ongoing, recruiting), Belgium (ongoing, recruiting), Greece (ongoing, recruiting), Slovakia (ongoing, recruiting), Denmark (ongoing, recruiting), Spain (ongoing, recruiting), Czechia (ongoing, recruiting), Germany (ongoing, recruiting).
Therapeutic area(s): Diseases [C] - Nervous System Diseases [C10]
Gender: Female, Male. Age: 18-64 years, 65+ years. Enrolment: 215.
Status: Ongoing, recruiting. Start date (EU): 2025-10-06. Decision date: 2025-08-01. Results received: No. Last updated: 2026-04-17.
Decision dates by country: SK: 2025-08-04, GR: 2025-08-05, BE: 2025-08-04, IT: 2025-08-05, DK: 2025-08-04, FR: 2025-08-05, CZ: 2026-04-17, DE: 2026-04-13, ES: 2025-08-05, PT: 2025-08-01

Condition(s): Relapsing multiple sclerosis
Product: OCRELIZUMAB, LOU064, OCRELIZUMAB

Primary endpoint: Annualized rate of new or enlarging T2 lesions (AR-NELT2) on MRI at Month 24 (relative to baseline MRI scan).
Endpoint(s): Participants with no evidence of disease activity-3 (NEDA-3), as assessed by absence of confirmed MS relapses, 6-month confirmed disability progression (6mCDP) and new/enlarging T2 lesions on MRI between baseline and Month 24., Adverse events, laboratory data, vital signs, electrocardiograms (ECGs), (Commercially confidential information)., Extension Part: Adverse events, laboratory data, vital signs, electrocardiogram (ECG), (Commercially confidential information)., Extension Part: - Annualized rate of new or enlarging T2 lesions on MRI - Participants with NEDA-3.

Source: https://euclinicaltrials.eu/ctis-public/view/2023-509275-17-00